EU clinical trial 2024-513929-23-00: A Phase 1/2/3 Study to Evaluate the Safety, Tolerability, and Efficacy of VX-880 in Subjects Who Have Type 1 Diabetes Mellitus With Impaired Hypoglycemic Awareness and Severe Hypoglycemia
Protocol code: VX20-880-101
Sponsor: Vertex Pharmaceuticals Inc. (Pharmaceutical company). Phase: Phase II and Phase III (Integrated). Countries: Norway (ongoing, recruiting), Netherlands (ongoing, recruiting), Germany (ongoing, recruiting), France (ongoing, recruiting), Italy (ongoing, recruiting).
Therapeutic area(s): Diseases [C] - Nutritional and Metabolic Diseases [C18]
Gender: Female, Male. Age: 18-64 years, 65+ years. Enrolment: 8.
Status: Ongoing, recruiting. Start date (EU): 2023-05-26. Decision date: 2024-10-02. Results received: No. Last updated: 2026-08-09.
Decision dates by country: FR: 2024-10-07, DE: 2024-10-08, IT: 2024-10-14, NL: 2024-10-02, NO: 2024-10-03

Condition(s): Type 1 Diabetes Mellitus with Impaired Hypoglycemic Awareness and Severe Hypoglycemia
Product: VX-880 solution for infusion

Primary endpoint: Part A - Safety and tolerability based on treatment-emergent adverse events (TEAEs; including incidence and severity of adverse events [AEs] and serious adverse events [SAEs]), clinical laboratory values, vital signs, standard 12-lead ECGs, and imaging findings, Part B and C - The following endpoints apply to the analysis of all infused subjects who intended to receive 0.8 × 10E9 total SC-islet cells with 1 infusion: •Proportion of subjects who are insulin independent at Day 365 after VX-880 infusion
Endpoint(s): Part B and C: Secondary Endpoints - Proportion of subjects free of SHEs from Day 90 through Day 365 (inclusive) and HbA1c <7.0% at Day 365 after VX 880 infusion, Part B and C: Secondary Endpoints - Change from baseline in HbA1c at Day 365 after VX-880 infusion, Part B and C: Secondary Endpoints- Proportion of subjects who achieve insulin independence and are insulin independent 12 months later, with absence of SHEs, Part B and C: Secondary Endpoints- Proportion of subjects who maintain insulin independence for at least 1 year, Part B and C: afety and tolerability based on TEAEs (including incidence and severity of AEs and SAEs), clinical laboratory values, vital signs, standard 12-lead ECGs, and imaging findings

Source: https://euclinicaltrials.eu/ctis-public/view/2024-513929-23-00